EU clinical trial 2023-509074-31-00: A PHASE 1/2 STUDY TO ASSESS THE SAFETY, TOLERABILITY, PHARMACOKINETICS, PHARMACODYNAMICS, AND EFFECTS ON CLINICAL OUTCOMES OF PEGTIBATINASE (TVT-058) ADMINISTERED SUBCUTANEOUSLY IN SUBJECTS WITH CYSTATHIONINE BETASYNTHASE-DEFICIENT HOMOCYSTINURIA (COMPOSE)
Protocol code: CBS-HCY-CT-01
Sponsor: Travere Therapeutics Switzerland GmbH, Travere Therapeutics Inc. (Pharmaceutical company). Phase: Phase I and Phase II (Integrated)- First administration to humans. Countries: France (authorised, recruitment pending).
Therapeutic area(s): Diseases [C] - Nutritional and Metabolic Diseases [C18]
Gender: Female, Male. Age: 0-17 years, 18-64 years, 65+ years. Enrolment: 6.
Status: Authorised, recruitment pending. Decision date: 2026-07-07. Results received: No. Last updated: 2026-07-07.

Condition(s): Classical Homocystinuria
Product: Pegtibatinase

Primary endpoint: Double-Blind Treatment Period (Cohorts 1-6): Incidence of adverse events (AEs) by type, severity, and relationship to study drug; Changes from baseline in clinical laboratory findings (serum chemistries, hematology, urinalysis, and coagulation parameters); 12-lead electrocardiogram (ECG) parameters; Presence and levels of anti-pegtibatinase and anti-polyethylene glycol (PEG) antibodies, Pediatric Open-label Treatment Period (Cohort 7): Incidence of AEs; Changes from baseline in vital signs, clinical laboratory findings; 12-lead ECG parameters; Immunogenicity (Anti-pegtibatinase antibodies, Anti-PEG antibodies, Neutralizing antibodies); Proportion of participants requiring dietary protein rescue; Incidence of hypermethioninemia; Incidence of hypomethioninemia
Endpoint(s): Double-Blind Treatment Period (Cohorts 1-6): Pegtibatinase levels following single and repeat administration at specified timepoints; Met cycle metabolites and Phe levels; Clinical efficacy endpoints (Ophthalmology, Bone densitometry, Cognitive assessments, Patient Reported Outcomes, Quality of life questionnaire), Pediatric Open-label Treatment Period (Cohort 7): • Plasma concentrations of pegtibatinase, including maximum concentration (Cmax), and area under curve (AUC), and additional PK parameters, as appropriate following single and repeat administration • The change from baseline in plasma tHcy levels • The change from baseline in plasma Met levels

Source: https://euclinicaltrials.eu/ctis-public/view/2023-509074-31-00